EU clinical trial 2024-510741-33-00: LADIGAGA - Long–term Analysis of DImethyl fumarate, to slow the Growth of Areas of Geographic Atrophy
Protocol code: P170919
Sponsor: Assistance Publique Hopitaux De Paris (Hospital/Clinic/Other health care facility). Phase: Therapeutic exploratory (Phase II). Countries: France (authorised, recruiting).
Therapeutic area(s): Diseases [C] - Eye Diseases [C11]
Gender: Female, Male. Age: 18-64 years, 65+ years. Enrolment: 90.
Status: Authorised, recruiting. Start date (EU): 2024-06-27. Decision date: 2024-06-27. Results received: No. Last updated: 2026-01-12.

Condition(s): Macular degeneration
Product: DIMETHYL FUMARATE, DIMETHYL FUMARATE

Primary endpoint: Rate of Change in Area of Geographic Atrophy (GA), based on masked, digital grading as measured on Fundus Auto-fluorescence ((FAF) Imaging Using a Confocal Scanning Ophthalmoscope by an External Reading Center at 12, Months compared to value at Baseline Day 1

Source: https://euclinicaltrials.eu/ctis-public/view/2024-510741-33-00